EU clinical trial 2025-523213-29-00: A Phase 1/2, Multicenter, Open-label, Dose Escalation and Expansion Clinical Study to Evaluate the Safety, Tolerability and Preliminary Efficacy of ASP2957 in Male Participants with Invasive Ventilator-dependent X-linked Myotubular Myopathy
Protocol code: 2957-CL-0101
Sponsor: Astellas Gene Therapies Inc. (Pharmaceutical company). Phase: Phase I and Phase II (Integrated)- First administration to humans. Countries: France (authorised, recruitment pending).
Therapeutic area(s): Diseases [C] - Musculoskeletal Diseases [C05]
Gender: Male. Age: 0-17 years. Enrolment: 3.
Status: Authorised, recruitment pending. Decision date: 2026-02-09. Results received: No. Last updated: 2026-07-14.

Condition(s): X-linked myotubular myopathy
Product: ASP2957

Primary endpoint: Incidence and severity of TEAEs and AESIs, Change from baseline in the following safety assessments through week 52: o clinical laboratory tests o cardiac findings from ECG and ECHO o muscle findings from muscle MRI and histopathology o physical examinations
Endpoint(s): Change from baseline in hours per day of ventilation support at week 52, ASP2957 vector DNA in serum through week 52, ASP2957 vector DNA in muscle biopsy at week 52, ASP2957 vector DNA in saliva, urine and stool, Immunogenicity of ASP2957 through week 52 as assessed with the following tests: o Anti-MyoAAV3.8 TAb and NAb o Anti-myotubularin Tab

Source: https://euclinicaltrials.eu/ctis-public/view/2025-523213-29-00